EU clinical trial 2023-506009-20-00: An Open-Label Study of Risdiplam in Infants with Genetically Diagnosed and Presymptomatic Spinal Muscular Atrophy
Protocol code: BN40703
Sponsor: F. Hoffmann-La Roche AG (Pharmaceutical company). Phase: Therapeutic exploratory (Phase II). Countries: Poland (ongoing, recruitment ended), Belgium (ended).
Therapeutic area(s): Diseases [C] - Nervous System Diseases [C10]
Gender: Female, Male. Age: 0-17 years. Enrolment: 6.
Start date (EU): 2019-03-29. Decision date: 2023-11-10. Results received: No. Last updated: 2025-07-07.
Decision dates by country: PL: 2023-11-10, BE: 2023-11-29

Condition(s): Spinal Muscular Atrophy (SMA)
Product: RO7034067, Evrysdi 0.75 mg/mL powder for oral solution, RO7034067

Primary endpoint: 1. The proportion of infants with two copies of the SMN 2 gene (excluding the known SMN2 gene modifier mutation c.859G> C) and baseline CMAP amplitude ≥1.5 mV who are sitting without support after 12 months of treatment. Sitting is defined as “sits without support for 5 seconds” as assessed in Item 22 of the Bayley Scales of Infant and Toddler Development®, Third Edition [BSIDIII] Gross Motor Scale.
Endpoint(s): 1. Proportion of patients developing clinically manifested SMA at month 12 and 24 of treatment, 2. Time to death or permanent ventilation, 3. Proportion of patients who are alive without permanent ventilation at Month12 and 24 of treatment, 4. Proportion of patients alive (at Month 12 and Month 24 of treatment), 5. Proportion of patients who achieve the attainment level of the motor milestones as assessed in the Hammersmith Infant Neurological Examination-2 (head control, sitting, voluntary grasp, ability to kick, rolling, crawling, standing, and walking) at Month 12 and 24 of treatment, 6. Proportion of patients sitting without support at Month 24 of treatment (as assessed in Item 22 of the BSID-III Gross Motor Scale) for 5 seconds, 7. Proportion of patients with two copies of the SMN2 gene sitting without support at Month 12 of treatment (as assessed in Item 22 of BSID-III Gross Motor Scale) for 5 seconds (independent of the CMAP value at baseline), 8. Proportion of patients sitting without support at Month 12 and 24 of treatment (as assessed in Item 26 of the BSID-III Gross Motor Scale) for 30 seconds, 9. Proportion of patients standing at Month 24 of treatment (defined as “Stands Alone” for at least 3 seconds as assessed in Item 40 of the BSID-III Gross Motor Scale), 10. Proportion of patients walking at Month 24 of treatment (defined as “Walks Alone” takes at least 3 steps as assessed in Item 42 of the BSID-III Gross Motor Scale), 11. Proportion of patients demonstrating the ability to achieve a scaled score within 1.5 standard deviations of the chronological reference standard (at Months 24 and 42 of treatment [as assessed through the use of the BSID-III Gross Motor Scale]), 12. Change from baseline score in the Children's Hospital of Philadelphia Infant Test of Neuromuscular Disorders (CHOP INTEND) motor function scale at Month 12 of treatment, 13. Proportion of patients who achieve a score of 40 or higher, 50 or higher and 60 or higher in the CHOP INTEND motor function scale at Month 12 of treatment, 14. Proportion of patients who meet CHOP INTEND stopping criteria at any point up to Month 24 of treatment, 15. Change from baseline (Month 24) in the Hammersmith Functional Motor Scale Expanded (HFMSE) (at Month 60 of treatment)., 16. Number and proportion of patients within 3rd percentile of normal range for weight-for-age, length/height-for-age, and weight-for-length/ height, (from enrollment) at Month 12, 24, 36, 48, and 60 of treatment, 17. Number and proportion of patients within 3rd percentile of normal range for head circumference for age at Month 12 and 24 of treatment, 18. Change from baseline percentiles for weight-for-age, length/height-for-age, and weight-for-length/height at Months 12, 24, 36, 48 and 60 of treatment, 19. Change from baseline percentiles for head circumference for age at Month 12 and Month 24 of treatment, 20. Change from baseline in chest circumference at Month 12 and 24 of treatment, 21. Ratio between chest and head circumferences at Month 12 and 24 of treatment, 22. Ability to swallow at Month 12, 24, 36, 48 and 60 of treatment, 23. Ability to feed orally at Month 12, 24, 36, 48 and 60 of treatment, 24. Change from baseline in CMAP amplitude at Month 12 and 24 of treatment, 25. SMN mRNA levels in blood, 26. SMN protein levels in blood, 27. Incidence and severity of adverse events with severity determined according to the National Cancer Institute Common Terminology Criteria for Adverse Events, Version 5 (NCI CTCAE) v5, 28. Incidence and severity of serious adverse events, 29. Incidence of treatment discontinuation due to adverse events, 30. Incidence of abnormal laboratory, ECG values and vital signs abnormalities, 31. Incidence of clinically significant findings on ophthalmological examination, 32. Plasma concentration of risdiplam and its metabolites, 33. Area under curve of risdiplam, 34. Concentration at the end of a dosing interval to assess steady-state, 35. Other PK parameters as appropriate

Source: https://euclinicaltrials.eu/ctis-public/view/2023-506009-20-00